EU clinical trial 2024-517846-32-00: DAVINCY trial: optimal Duration of (fos)Aprepitant prophylaxis for nausea and Vomiting INduced by ChemotherapY in children: a double-blind placebo-controlled crossover randomized phase III trial.
Sponsor: Prinses Maxima Centrum voor Kinderoncologie B.V. (Hospital/Clinic/Other health care facility). Phase: Therapeutic confirmatory (Phase III). Countries: Netherlands (ended).
Therapeutic area(s): Analytical, Diagnostic and Therapeutic Techniques and Equipment [E] - Therapeutics [E02]; Diseases [C] - Neoplasms [C04]
Gender: Female, Male. Age: 0-17 years. Enrolment: 76.
Status: Ended. Start date (EU): 2021-12-21. End date (EU): 2026-04-06. Decision date: 2024-11-15. Results received: No. Last updated: 2026-02-05.

Condition(s): Delayed chemotherapy induced nausea and vomiting (CINV)
Product: IVEMEND 150 mg powder for solution for infusion, Aprepitant Placebo Tablet, Aprepitant Teva 80 mg, harde capsules, NaCl I.V.

Primary endpoint: The proportion of patients who achieved complete response (defined as no vomiting, no retching and no use of rescue medication) during the >24-72 hours after the final dose of chemotherapy (delayed phase).
Endpoint(s): Proportion of patients who: - achieved complete response during the course of chemotherapy until 24h after the final dose of chemotherapy (acute phase) - achieved complete response during both the acute and delayed phase (overall phase), Time from initiation of emetogenic chemotherapy to: 1. the first vomiting episode 2. the first rescue medication use, Safety of prolonged use of (fos)aprepitant (AEs considered related by the investigators)., Pharmacokinetic (PK) parameters (i.e. clearance and volume of distribution) and influ-encing PK co-variates as chemotherapeutics., Improvement of CINV complaints according to the Pediatric Nausea Assessment tool (PeNAT) and the Baxter Retching Faces (BARF)., Validity, responsiveness and feasibility of PeNAT and BARF., Cost-effectiveness of prolonged (fos)aprepitant dosing regimen.

Source: https://euclinicaltrials.eu/ctis-public/view/2024-517846-32-00